EU clinical trial 2025-524136-19-00: A Phase 1 Study Investigating the Safety, Tolerability, Pharmacokinetics, Pharmacodynamics, and Preliminary Antitumor Activity of BGB-B2033, Alone or in Combination With Tislelizumab With or Without Bevacizumab, in Participants With Selected Advanced or Metastatic Solid Tumors
Protocol code: BGB-B2033-101
Sponsor: BeOne Medicines AG (Pharmaceutical company). Phase: Human Pharmacology (Phase I)- First administration to humans. Countries: Italy (ongoing, recruiting), France (ongoing, recruiting).
Therapeutic area(s): Diseases [C] - Neoplasms [C04]
Gender: Female, Male. Age: 18-64 years, 65+ years. Enrolment: 56.
Status: Ongoing, recruiting. Start date (EU): 2026-04-28. Decision date: 2026-04-15. Results received: No. Last updated: 2026-06-04.
Decision dates by country: FR: 2026-04-15, IT: 2026-04-15

Condition(s): Selected Advanced or Metastatic Solid Tumors

Source: https://euclinicaltrials.eu/ctis-public/view/2025-524136-19-00